EU clinical trial 2024-519825-39-00: ANALYSIS OF EFFECTIVENESS OF NEOADJUVANT CHEMOTHERAPY IN THE TREATMENT OF LOCALLY ADVANCED COLON CANCER.
Protocol code: ELECLA
Sponsor: Clinica Universidad De Navarra (Hospital/Clinic/Other health care facility). Phase: Therapeutic exploratory (Phase II). Countries: Spain (ongoing, recruiting).
Therapeutic area(s): Diseases [C] - Digestive System Diseases [C06]; Diseases [C] - Neoplasms [C04]
Gender: Female, Male. Age: 18-64 years, 65+ years. Enrolment: 238.
Status: Ongoing, recruiting. Start date (EU): 2025-01-30. Decision date: 2025-01-30. Results received: No. Last updated: 2025-01-30.

Condition(s): Locally advanced colon cancer (LACC)
Product: Oxaliplatin Hospira 5 mg/ml concentrate for solution for infusion, Capecitabine Accord 150 mg film-coated tablets

Primary endpoint: 2 years disease-free survival
Endpoint(s): Disease-free survival (DFS) and overall survival (OS) at 5 years after randomization, Postoperative morbidity and mortality: Frequency and type of postoperative complications and transfusion requirements, Presence of local or distant recurrence and its location., Toxicity, according to the CTCAE scale (Common Terminology Criteria for Adverse Events) version 4.0., Degree of therapeutic completion in each of the groups., Accuracy of CT to adequately diagnose LACC in the control group, studying the correlation between the staging of the preoperative CT and that given by the pathological analysis, Information provided by the restaging CT with the degree of regression at the pathological level: Sensitivity, Specificity, Positive/Negative Predictive Value will be calculated., Utility of the scales commonly used in the assessment of the pathological tumor response in rectal cancer to determine this response in colon cancer, after neoadjuvant treatment., In the group of patients over 70 years of age receiving neoadjuvant chemotherapy, whether the addition of oxaliplatin impacts the pathological response.

Source: https://euclinicaltrials.eu/ctis-public/view/2024-519825-39-00